EU clinical trial 2022-501078-20-00: A Phase 2, Randomized, Open-Label Study of Two Dose Levels of Vobramitamab Duocarmazine in Participants with Metastatic Castration-Resistant Prostate Cancer (TAMARACK)
Protocol code: CP-MGC018-03
Sponsor: Macrogenics Inc. (Pharmaceutical company). Phase: Therapeutic exploratory (Phase II). Countries: Belgium (ended), Germany (ended), France (ended), Italy (ended), Poland (ended), Spain (ended), Czechia (ended).
Therapeutic area(s): Diseases [C] - Neoplasms [C04]
Gender: Male. Age: 18-64 years, 65+ years. Enrolment: 61.
Status: Ended. Start date (EU): 2023-05-15. End date (EU): 2025-01-23. End date: 2025-01-24. Decision date: 2023-02-17. Results received: Yes. Last updated: 2025-02-04.
Decision dates by country: CZ: 2023-02-21, DE: 2023-02-22, FR: 2023-02-17, IT: 2023-02-23, PL: 2023-02-27, ES: 2023-02-21, BE: 2023-02-21

Condition(s): Metastatic Castration-resistant Prostate Cancer
Product: Prednison acis 20 mg, MGC018

Primary endpoint: rPFS per PCWG3 criteria
Endpoint(s): PSA response rate per PCWG3 criteria, Time to PSA progression per PCWG3 criteria, Duration of PSA response per PCWG3 criteria, PSA percent change over time, Best PSA percent change, ORR by investigator assessment per PCWG3 criteria, DoR by investigator assessment per PCWG3 criteria, Time to first symptomatic skeletal event (SSE), Number of participants with adverse event (AEs), serious AEs (SAEs), and AEs leading to study treatment discontinuation., Concentrations and PK parameters for vobramitamab duocarmazine (and metabolites as appropriate), Incidence of anti-drug antibodies (ADA) formation against vobramitamab duocarmazine

Source: https://euclinicaltrials.eu/ctis-public/view/2022-501078-20-00